EU clinical trial 2024-513983-24-00: EMMA - Medico Economic Evaluation of Fluocinolone Acetonide Implant Versus Dexametheasone Implant in Resistant Diabetic Macular Oedema
Sponsor: Centre Hospitalier Universitaire De Dijon (Hospital/Clinic/Other health care facility). Phase: Therapeutic use (Phase IV). Countries: France (ongoing, recruiting).
Therapeutic area(s): Diseases [C] - Eye Diseases [C11]
Gender: Female, Male. Age: 18-64 years, 65+ years. Enrolment: 106.
Status: Ongoing, recruiting. Start date (EU): 2021-10-29. Decision date: 2024-07-09. Results received: No. Last updated: 2025-04-30.

Condition(s): Diabetic Macular Oedema
Product: ILUVIEN 190 microgrammes, implant intravitréen avec applicateur, OZURDEX 700 micrograms intravitreal implant in applicator

Primary endpoint: Incremental cost-utility ratio at 3 years, from a societal point of view, expressed in terms of cost per year of life gained in good health (cost/QALY).
Endpoint(s): BCVA measured using the ETDRS at each follow-up visit (including inclusion): Construction of the average variation using the AUC approach over the 0-12 month, 0-24 month and 0-36 month periods, BCVA measured using the ETDRS at each follow-up visit (including inclusion): Construction of the difference between inclusion and 12, 24 and 36 months, BCVA measured using the ETDRS at each follow-up visit (including inclusion): Construction of the gain ≥15 letters (yes/no) variable at 12, 24 and 36 months compared with inclusion, BCVA measured using the ETDRS at each follow-up visit (including inclusion): Construction of the "BCVA involvement" ≥80 letters (yes/no) variable at 12, 24 and 36 months compared with inclusion, Central retinal thickness, measured as the central foveolar thickness by optical coherence tomography at inclusion, 12, 24, and 36 months: construction of the difference between inclusion and 12, 24 and 36 months, Treatment regimen (number of injections and time to re-injection), Additional ophthalmological treatments and visits compared with conventional follow-up., VFQ-25 quality of life scores at baseline and at 12, 24 and 36 months, Adverse events (ocular hypertonia with initiation of a new treatment or filtering surgery, endophthalmitis, retinal detachment, etc.) at 12, 24 and 36 months., Incremental cost-effectiveness ratio at 3 years expressed in terms of cost per life-year gained, then in terms of cost per case of visual impairment avoided (visual impairment being defined by a result of 4/10ths, i.e. 65 letters ETDRS) and finally in terms of cost per case of legal blindness avoided (blindness being defined by a BCVA ≤ 1/20th, i.e. 20 letters ETDRS), Net financial impact of widespread use of the FA implant on the compulsory health insurance budget: costs incurred, costs avoided.

Source: https://euclinicaltrials.eu/ctis-public/view/2024-513983-24-00